EU clinical trial 2022-502424-43-00: A randomised, single-blind, placebo-controlled trial to investigate safety, tolerability, and pharmacokinetics of single rising doses of BI 3000202 administered as tablet to healthy male subjects, and a randomised, open-label, single-dose, two-way cross-over relative bioavailability comparison of BI 3000202 as tablet with and without food in healthy male subjects
Protocol code: 1509-0001
Sponsor: Boehringer Ingelheim International GmbH (Pharmaceutical company). Phase: Human Pharmacology (Phase I)- First administration to humans. Countries: Germany (ended).
Therapeutic area(s): Not possible to specify
Gender: Male. Age: 18-64 years. Enrolment: 68.
Status: Ended. Start date (EU): 2023-07-25. End date (EU): 2023-11-13. Decision date: 2023-06-14. Results received: Yes. Last updated: 2023-06-14.

Condition(s): Healthy volunteer trial
Product: Placebo matching BI 3000202

Primary endpoint: SRD part: Occurrence of any treatment-emergent adverse event assessed as drug-related by the investigator. This is expressed as the percentage of subjects treated with investigational drug who experience such an event., FE part: AUC0-24 (area under the concentration-time curve of the analyte in plasma over the dosing interval 0 to 24 hours), FE part: Cmax (maximum measured concentration of the analyte in plasma)
Endpoint(s): SRD part: AUC0-24 (area under the concentration-time curve of the analyte in plasma over the dosing interval 0 to 24 hours), SRD part: Cmax (maximum measured concentration of the analyte in plasma), FE part: AUC0-∞ (area under the concentration-time curve of the analyte in plasma over the time interval from 0 extrapolated to infinity)

Source: https://euclinicaltrials.eu/ctis-public/view/2022-502424-43-00